EU clinical trial 2024-516174-30-01: Investigation of pregabalin therapy and complex rehabilitation in treating chronic fatigue associated with post-COVID syndrome
Protocol code: NIGRIR_001POSTCOVID
Sponsor: Narodowy Instytut Geriatrii Reumatologii I Rehabilitacji Im Prof. Dr Hab. Med. Eleonory Reicher (Hospital/Clinic/Other health care facility). Phase: Therapeutic exploratory (Phase II). Countries: Poland (ended).
Therapeutic area(s): Diseases [C] - Nervous System Diseases [C10]
Gender: Female, Male. Age: 18-64 years. Enrolment: 132.
Status: Ended. Start date (EU): 2023-03-08. End date (EU): 2025-10-30. Decision date: 2024-10-31. Results received: No. Last updated: 2024-10-31.

Condition(s): Chronic fatigue syndrome associated with post-COVID syndrome
Product: Preato,75 mg, tabletki, Preato-Placebo

Primary endpoint: Change in fatigue intensity expressed as a difference in Multidimensional Fatigue Inventory-20 (MFI-20) score at 3 and 6 months of the study relative to the baseline score., Walking distance as a difference in score from the 6 Minute Walking Test at 3 and 6 months compared to baseline.
Endpoint(s): Change in the degree of satisfaction with life expressed as the result of the Life Satisfaction Scale (Juczyński) in the 3rd and 6th month of the study compared to the result on the day the study began., Change in the result obtained in the "Beck Depression Inventory (BDIII)" in the 3rd and 6th month of the study compared to the result on the day the study began., Change in the result obtained in the anxiety test - State and Trait Anxiety Inventory (STAI) in the 3rd and 6th month of the study compared to the result on the day the study began., Change in the degree of acceptance of the disease assessed by the Illness Acceptance Scale (Juczyński) in the 3rd and 6th month of the study in relation to the result on the day the study began., Change in the CTT-1 and CTT-2 test result in the 3rd and 6th month of the study compared to the result on the day the study began., Change in the result of the Wisconsin Card Sorting Test (WCST) in the 3rd and 6th month of the study compared to the result on the day the study began., Change in the RFFT test result in the 3rd and 6th month of the study compared to the result on the day the study began., Change in the result in the WAIS-R Digit Repetition subtest in the 3rd and 6th month of the study compared to the result on the day the study began., Change in reaction time in the Stroop interference test in the 3rd and 6th month of the study compared to the result on the day the study began., Change in the gait quality assessment in the 3rd and 6th month of the study compared to the result on the day the study began., Change in walking speed in the 3rd and 6th month of the study compared to the result on the day the study began., Change in reaction time expressed in the Peg Insertion Test in the 3rd and 6th month of the study compared to the result on the day the study began., Change in the d2-R test result in the 3rd and 6th month of the study compared to the result on the day the study began., Change in the score on the Athens Insomnia Scale in the 3rd and 6th month of the study compared to the score on the day the study began., Change in the Mini-Cope result in the 3rd and 6th month of the study compared to the result on the day the study began., The exploratory endpoint is the change in the profile of tested inflammatory cytokines in the 6th month of the study compared to the result before the start of the study. We allow for the possibility of additional exploratory endpoints during the study, before unblinding., Security related endpoints: • Number of adverse events and the number and percentage of patients who experienced adverse events. • Number of adverse events and the number and proportion of patients who experienced treatment-related adverse events. • Number of serious adverse events and number and proportion of patients with serious adverse events. • Number of serious adverse events and the number and proportion of patients who experienced treatment-related serious adverse events., Number and percentage of patients who discontinued participation in the study due to an adverse event - changes in laboratory parameters and basic vital signs.

Source: https://euclinicaltrials.eu/ctis-public/view/2024-516174-30-01